EU clinical trial 2024-518772-32-00: A randomised, prospective phase II study of pharmacokinetics and safety aspects of higher doses of rifampicin and pyrazinamide in a shortened treatment of mild-to-moderate tuberculosis compared with standard of care
Protocol code: HIGH-SHORT RP
Sponsor: Region Oestergoetland (Hospital/Clinic/Other health care facility). Phase: Therapeutic exploratory (Phase II). Countries: Sweden (authorised, recruitment pending).
Therapeutic area(s): Diseases [C] - Bacterial Infections and Mycoses [C01]
Gender: Female, Male. Age: 18-64 years, 65+ years. Enrolment: 40.
Status: Authorised, recruitment pending. Decision date: 2024-10-18. Results received: No. Last updated: 2024-10-18.

Condition(s): Tuberculosis
Product: PYRAZINAMIDE, RIFAMPICIN

Primary endpoint: The primary variable is the area under concentration and time curve (AUC0-24h) for high-dose RIF in a combination regimen with high-dose PZA on day 1 after the first dose and at week 2.

Source: https://euclinicaltrials.eu/ctis-public/view/2024-518772-32-00